EU clinical trial 2026-525844-14-00: Study of 3 Monoclonal Antibodies (REGN9933, REGN7508, and REGN9533) in Adult Participants with End-Stage Kidney Disease on Hemodialysis
Protocol code: R9533-HD-2576
Sponsor: Regeneron Pharmaceuticals Inc. (Pharmaceutical company). Phase: Human Pharmacology (Phase I)- Other. Countries: Belgium (authorised, recruitment pending).
Therapeutic area(s): Diseases [C] - Hemic and Lymphatic Diseases [C15]
Gender: Female, Male. Age: 18-64 years, 65+ years. Enrolment: 36.
Status: Authorised, recruitment pending. Decision date: 2026-07-03. Results received: No. Last updated: 2026-07-03.

Condition(s): End-Stage Kidney Disease (ESKD)

Source: https://euclinicaltrials.eu/ctis-public/view/2026-525844-14-00